EU clinical trial 2025-524283-38-00: HOVON 182 CLL: Prospective randomized phase 3 study of treatment with rituximab (6 cycles) in combination with 6 or 26 cycles of venetoclax in patients with relapsed or refractory chronic lymphocytic leukemia RED RIVER CLL study: Reduced Duration Rituximab VEnetoclax in Relapsed/refractory CLL
Protocol code: HOVON 182 CLL
Sponsor: Hemato-Oncologie voor Volwassenen Nederland (Hovon) Stichting (Patient organisation/association). Phase: Therapeutic confirmatory (Phase III). Countries: Netherlands (authorised, recruitment pending).
Therapeutic area(s): Diseases [C] - Hemic and Lymphatic Diseases [C15]
Gender: Female, Male. Age: 18-64 years, 65+ years. Enrolment: 456.
Status: Authorised, recruitment pending. Decision date: 2026-06-08. Results received: No. Last updated: 2026-06-17.

Condition(s): Relapsed or refractory chronic lymphocytic leukemia, Relapsed or refractory small lymphocytic lymphoma
Product: Venclyxto 10 mg film-coated tablets, Venclyxto 50 mg film-coated tablets, Venclyxto 100 mg film-coated tablets

Primary endpoint: PFS, defined as the time from randomization to the first occurrence of disease progression or death due to any cause, whichever occurs first.
Endpoint(s): ORR, defined as the proportion of patients with a complete response (CR), complete response with incomplete marrow recovery (CRi), or partial response (PR) according to IWCLL 2018 criteria., OS, defined as the time from randomization to death due to any cause. Patients still alive at date of last contact will be censored., EFS, defined as time from randomization to progression, death or premature cessation of venetoclax due to toxicity, whichever comes first., TTNT, defined as time from randomization to start of next new line of CLL treatment., ORR2, defined as the proportion of patients with a complete response (CR), complete response with incomplete marrow recovery (CRi), or partial response (PR) according to IWCLL 2018 criteria after next line of treatment., PFS2, time from randomization to the earliest occurrence of either second disease progression or death from any cause, following the initiation of the next line of treatment., Depth (level) of MRD based on flow cytometry measured in peripheral blood at baseline, randomization and week 84 after randomization., Type, frequency, and severity of AEs and their relationship to study treatment (determined according to National Cancer Institute (NCI) Common Terminology Criteria for Adverse Events (CTCAE) v6.0)., Health-related quality of life (QoL) as assessed by EORTC QLQ-C30, QLQ-CLL17 and PRO-CTCAE questionnaires.

Source: https://euclinicaltrials.eu/ctis-public/view/2025-524283-38-00